EU clinical trial 2023-506769-67-00: A Phase 2, Multicenter, Randomized, Placebo-Controlled, Double-Blind Induction Study to Evaluate the Efficacy and Safety of Oral TAK-279 in Subjects With Moderately to Severely Active Ulcerative Colitis
Protocol code: TAK-279-UC-2001
Sponsor: Takeda Development Center Americas Inc. (Pharmaceutical company). Phase: Therapeutic exploratory (Phase II). Countries: Italy (ongoing, recruitment ended), Hungary (ongoing, recruitment ended), Belgium (ongoing, recruitment ended), Denmark (ongoing, recruitment ended), Romania (ongoing, recruitment ended), Slovakia (ongoing, recruitment ended), Czechia (ongoing, recruitment ended), Poland (ongoing, recruitment ended), Norway (ongoing, recruitment ended), Germany (ongoing, recruitment ended), France (ongoing, recruitment ended), Greece (ongoing, recruitment ended), Bulgaria (ongoing, recruitment ended).
Therapeutic area(s): Diseases [C] - Digestive System Diseases [C06]
Gender: Female, Male. Age: 18-64 years, 65+ years. Enrolment: 200.
Status: Ongoing, recruitment ended. Start date (EU): 2024-09-04. Decision date: 2024-07-16. Results received: No. Last updated: 2026-07-13.
Decision dates by country: SK: 2024-07-17, GR: 2024-07-22, BE: 2024-07-19, CZ: 2024-07-18, DE: 2024-07-17, BG: 2025-06-17, FR: 2024-07-22, IT: 2024-07-17, PL: 2024-09-04, NO: 2024-07-17, DK: 2024-07-16, HU: 2024-07-17, RO: 2024-07-22

Condition(s): Moderate to Severely Active Ulcerative Colitis
Product: ZASOCITINIB, TAK-279 Placebo (same excipient as TAK-279)

Primary endpoint: Clinical remission at Week 12, assessed as the proportion of subjects achieving a modified Mayo score of ≤2 with stool frequency subscore of ≤1, rectal bleeding subscore of 0, and centrally read endoscopic subscore of ≤1 (score of 1 modified to exclude friability).
Endpoint(s): Clinical response at Week 12, assessed as the proportion of subjects achieving a reduction from baseline in modified Mayo score of ≥2 points and ≥30% from baseline and a decrease from baseline in the rectal bleeding subscore of ≥1 point or an absolute rectal bleeding subscore of ≤1 point., Symptomatic remission at Week 12, assessed as the proportion of subjects achieving a rectal bleeding subscore of 0 and stool frequency subscore of ≤1., Endoscopic improvement at Week 12, assessed as the proportion of subjects achieving a modified Mayo endoscopic subscore of ≤1 (score of 1 modified to exclude friability)., Endoscopic remission at Week 12, assessed as the proportion of subjects achieving a modified Mayo endoscopic subscore of 0., Proportion of subjects with no bowel urgency as measured by the bowel urgency electronic diary (eDiary) item at Week 12., Proportion of subjects with no abdominal pain as measured by the abdominal pain eDiary item at Week 12., Disease-specific HRQoL as measured by the Inflammatory Bowel Disease Questionnaire (IBDQ) at Week 12, assessed as the proportion of subjects with total score ≥170., Change from baseline in disease-specific HRQoL as measured by the IBDQ total score at Week 12., Change from baseline in fatigue as measured by the Functional Assessment of Chronic Illness Therapy – Fatigue (FACIT-Fatigue) score at Week 12.

Source: https://euclinicaltrials.eu/ctis-public/view/2023-506769-67-00